EU clinical trial 2024-510981-18-00: Free regimen of Dexamethasone as initial therapy for advanced relapsed/refractory multiple myeloma: an open-label randomized, non-inferiority, controlled trial (FREEDOM)
Protocol code: APHP231089
Sponsor: Assistance Publique Hopitaux De Paris (Hospital/Clinic/Other health care facility). Phase: Therapeutic confirmatory (Phase III). Countries: France (ongoing, recruiting).
Therapeutic area(s): Diseases [C] - Hemic and Lymphatic Diseases [C15]
Gender: Female, Male. Age: 18-64 years, 65+ years. Enrolment: 334.
Status: Ongoing, recruiting. Start date (EU): 2024-12-12. Decision date: 2024-07-23. Results received: No. Last updated: 2025-11-17.

Condition(s): Multiple Myeloma Multiple myeloma (MM) is a B cell malignancy and is one of the most frequent primary neoplasms of the bone marrow
Product: DEXAMETHASONE, DEXAMETHASONE, DEXAMETHASONE

Primary endpoint: the ORR after six cycles of salvage therapy, defined as the proportion of subjects who achieve complete response (CR) or partial response (PR) according to the IMWG criteria, following salvage therapy.

Source: https://euclinicaltrials.eu/ctis-public/view/2024-510981-18-00